EU clinical trial 2023-504350-36-00: Phase I study of MGY825 in patients with lung cancer
Protocol code: CMGY825A12101
Sponsor: Novartis Pharma AG (Pharmaceutical company). Phase: Human Pharmacology (Phase I)- First administration to humans. Countries: Germany (ended), Spain (ended).
Therapeutic area(s): Diseases [C] - Neoplasms [C04]
Gender: Female, Male. Age: 18-64 years, 65+ years. Enrolment: 50.
Status: Ended. Start date (EU): 2022-11-25. End date (EU): 2025-10-13. End date: 2025-10-14. Decision date: 2023-12-12. Results received: No. Last updated: 2025-07-14.
Decision dates by country: DE: 2023-12-14, ES: 2023-12-12

Condition(s): Advanced non-small cell lung cancer with or without NFE2L2/KEAP1/CUL3 mutations in adult patients

Source: https://euclinicaltrials.eu/ctis-public/view/2023-504350-36-00